EU clinical trial 2022-502585-25-00: Multicentric Phase 1 Study With Escalation of Doses of Daratumumab in Combination With Chemotherapy (Idarubicin and Cytarabine) or CPX-351 in Patients of 60 years old or more With adverse Risk Acute Myeloblastic Leukemia (AML) (DARALAM)
Protocol code: RC22_0372
Sponsor: Centre Hospitalier Universitaire De Nantes (Hospital/Clinic/Other health care facility). Phase: Human Pharmacology (Phase I)- Other. Countries: France (ongoing, recruiting).
Therapeutic area(s): Diseases [C] - Hemic and Lymphatic Diseases [C15]
Gender: Female, Male. Age: 18-64 years, 65+ years. Enrolment: 12.
Status: Ongoing, recruiting. Start date (EU): 2025-02-06. Decision date: 2023-02-07. Results received: No. Last updated: 2025-02-19.

Condition(s): Adult patients with adverse Risk Acute Myeloblastic Leukemia

Source: https://euclinicaltrials.eu/ctis-public/view/2022-502585-25-00